EU clinical trial 2023-504736-18-00: A Phase 2/3, Randomized, Double-blind, Placebo-and Active-controlled, Parallel-group, Multicenter Protocol to Evaluate the Efficacy and Safety of Guselkumab in Participants with Moderately to Severely Active Crohn's Disease
Protocol code: CNTO1959CRD3001
Sponsor: Janssen - Cilag International (Pharmaceutical company). Phase: Phase II and Phase III (Integrated). Countries: Hungary (ongoing, recruitment ended), Poland (ongoing, recruitment ended), Netherlands (ongoing, recruitment ended), Portugal (ongoing, recruitment ended), Italy (ongoing, recruitment ended), Latvia (ongoing, recruitment ended), Germany (ongoing, recruitment ended), Slovakia (ongoing, recruitment ended), Croatia (ended), Belgium (ongoing, recruitment ended), Spain (ongoing, recruitment ended), France (ongoing, recruitment ended), Czechia (ongoing, recruitment ended).
Therapeutic area(s): Diseases [C] - Immune System Diseases [C20]
Gender: Female, Male. Age: 18-64 years, 65+ years. Enrolment: 474.
Start date (EU): 2018-07-26. Decision date: 2024-08-01. Results received: No. Last updated: 2026-06-19.
Decision dates by country: HR: 2024-08-09, DE: 2024-08-06, NL: 2024-08-02, CZ: 2024-08-05, LV: 2024-08-12, FR: 2024-08-12, SK: 2024-08-06, PL: 2024-08-29, PT: 2024-09-16, HU: 2024-08-01, IT: 2024-08-07, BE: 2024-08-02, ES: 2024-08-13

Condition(s): Moderately to Severely Active Crohn's Disease
Product: Placebo for Ustekimumab, STELARA 90 mg solution for injection in pre-filled syringe, Placebo for Guselkumab, STELARA 130 mg concentrate for solution for infusion, Guselkumab, Guselkumab - solution for injection in pre-filled syringe - 100 mg/mL

Primary endpoint: Phase 2: Change from Baseline in the Crohn's Disease Activity Index (CDAI) Score at Week 12, Phase 3: Global co-primary endpoints: - clinical response at Week 12 and clinical remission at Week 48 - clinical response at Week 12 and endoscopic response at Week 48. Regional co-primary endpoints: - clinical remission at Week 12 - endoscopic response at Week 12

Source: https://euclinicaltrials.eu/ctis-public/view/2023-504736-18-00